EU clinical trial 2024-514348-95-00: APIS Apixaban for Intrahepatic Non Cirrhotic Portal Hypertension
Protocol code: P170916J
Sponsor: Assistance Publique Hopitaux De Paris (Hospital/Clinic/Other health care facility). Phase: Therapeutic confirmatory (Phase III). Countries: France (ended).
Therapeutic area(s): Diseases [C] - Hemic and Lymphatic Diseases [C15]
Gender: Female, Male. Age: 18-64 years, 65+ years. Enrolment: 166.
Status: Ended. Start date (EU): 2019-06-24. End date (EU): 2026-06-10. Decision date: 2024-07-10. Results received: No. Last updated: 2025-10-28.

Condition(s): Intrahepatic non-cirrhotic portal hypertension
Product: Placebo of Eliquis 2.5 mg, Eliquis 2.5 mg film-coated tablets

Primary endpoint: Within 24 months after randomisation, cumulative incidence of occurrence or progression (according to VALDIG PVT criteria) of portal venous system thrombosis (including splenic and/or superior mesenteric vein and/or inferior mesenteric vein and/or portal trunk and/or one of the 2 portal branches), determined using a CT scan with centralized imaging blinded review

Source: https://euclinicaltrials.eu/ctis-public/view/2024-514348-95-00